EU clinical trial 2023-504176-25-00: AGORA-1 /ALFA 2100 study : A Phase 2 Study of Gemtuzumab Ozogamicin (GO)-Gilteritinib Combination in Adults with FLT3-ITD and/or FLT3-TKD relapse/refractory (R/R) AML
Protocol code: 2020/65
Sponsor: Centre Antoine Lacassagne (Health care). Phase: Phase I and Phase II (Integrated)- Other. Countries: France (ongoing, recruitment ended).
Therapeutic area(s): Diseases [C] - Neoplasms [C04]
Gender: Female, Male. Age: 18-64 years, 65+ years. Enrolment: 50.
Status: Ongoing, recruitment ended. Start date (EU): 2024-08-08. Decision date: 2024-08-08. Results received: No. Last updated: 2026-05-26.

Condition(s): Acute Myeloid Leukemia
Product: MYLOTARG 5 mg powder for concentrate for solution for infusion, Xospata 40 mg film-coated tablets

Primary endpoint: Stage 1 of the study: assessment of safety of the addition of gilteritinib to the AGORA treatment platform Safety of combining gilteritinib with the GO-cytarabine AGORA platform in patients with FLT3-ITD and/or FLT3-TKD mutated R/R AML will be assessed through the identification of dose-limiting toxicities (DLTs) if any., Stage 2 of the study: assessment of efficacy of gilteritinib-combined to GO/cytarabine AGORA platform through EFS. The definition of EFS will be adapted to the current real-life setting, including the increasing number of experimental options. Actually, the decision to switch toward another therapy may be influenced by other events than hematologic relapse, like suboptimal tolerance or MRD monitoring or simply availability of new promising options.
Endpoint(s): Response rate, including CR, CRi and CRh*; the overall response rate (ORR) being defined as CR/CRi/CRh rates *: CRi, CR with incomplete hematologic recovery, meaning CR with platelet count <100,000/µL or absolute neutrophil count <1000/µL; CRh, CR with partial hematologic recovery, meaning CR not fulfilling CR or CRi criteria but with platelet count >50,000/µL AND absolute neutrophil count >500/µL., Early mortality rates, at day-30, Incidence of subsequent allogeneic HSCT, overall and in responding patients specifically, Duration of response (DOR), relapse-free survival (RFS) and overall survival (OS), Subgroup analyses: • Subgroups defined by a patient related factor: age (<65 vs ≥65y), • Subgroups defined by disease related factors: cytogenetics, mutation profiles (including NPM1 and FLT3-ITD), ELN-risk classification 2022 • Subgroups defined by treatment related factor by the performance of a subsequent allogeneic HSCT, Safety through the occurrence of (AEs), serious adverse events (SAEs), and treatment emergent adverse events (TEAEs), Patient reported outcome

Source: https://euclinicaltrials.eu/ctis-public/view/2023-504176-25-00